EU clinical trial 2025-523474-16-00: A Phase 1/2, Open-label Study of Oral S241656 (BDTX-4933) as Monotherapy and in Combination with Other Anti-Cancer Therapies in Patients with KRAS, BRAF and Other Selected RAS/MAPK Mutation-Positive Malignancies
Protocol code: BDTX-4933-101
Sponsor: Institut De Recherches Internationales Servier IRIS (Pharmaceutical company). Phase: Phase I and Phase II (Integrated)- First administration to humans. Countries: France (authorised, recruitment pending), Spain (authorised, recruitment pending), Denmark (ongoing, recruiting), Italy (ongoing, recruiting).
Therapeutic area(s): Diseases [C] - Neoplasms [C04]
Gender: Female, Male. Age: 18-64 years, 65+ years. Enrolment: 105.
Start date (EU): 2026-06-09. Decision date: 2026-04-21. Results received: No. Last updated: 2026-08-07.
Decision dates by country: DK: 2026-04-21, FR: 2026-04-22, IT: 2026-04-22, ES: 2026-04-24

Condition(s): Malignancies with Documented KRAS, BRAF and Other Selected RAS/MAPK Mutations
Product: Gemcitabin Hikma 38 mg/ml Konzentrat zur Herstellung einer Infusionslösung, Fluorouracil Hikma 50 mg/ml Injektionslösung, Vectibix 20 mg/ml concentrate for solution for infusion, Irinotecan Kabi 20 mg/ml Konzentrat zur Herstellung einer Infusionslösung, Bugvi 5 mg/ml pulbere pentru dispersie perfuzabilă, S241656 film-coated tablet 50mg, S241656 film-coated tablet 25mg, Erbitux 5 mg/mL solution for infusion, Oxaliplatin Kabi 5 mg/ml Konzentrat zur Herstellung einer Infusionslösung, S241656 film-coated tablet 200mg, FOLINATE DE CALCIUM HIKMA 10 mg/mL, solution injectable/pour perfusion

Primary endpoint: Dose Escalation: Incidence of dose-limiting toxicities occurring within the first 28-day cycle Number of Adverse Events and Serious Adverse Events Dose Expansion: Objective response
Endpoint(s): 1. Dose Escalation: PK parameters of S241656 and its metabolite S243796, including but not limited to Cmax, tmax, AUC, and t½, 2. Dose Escalation: Objective response Disease Control Clinical Benefit Duration of Response Time to response Progression free survival Overall survival, 3. Dose Escalation: Clinical efficacy parameters Safety and tolerability parameters PK including: Exposure-toxicity relationship, 4. Dose Expansion: Clinical Efficacy Parameters Safety and Tolerability Parameters PK & PD parameters, 5. Dose Expansion: Disease Control Clinical Benefit Duration of Response Time to Response Progression free survival Overall Survival, 6. Dose Expansion: PK parameters of S241656 and its metabolite S243796, but not limited to Cmax, tmax, AUC, and t½

Source: https://euclinicaltrials.eu/ctis-public/view/2025-523474-16-00